EU clinical trial 2022-502031-20-00: A Phase II/III, Randomized, Double-Blind, Placebo-Controlled Study of Tiragolumab in combination with Atezolizumab plus Pemetrexed and Carboplatin/Cisplatin versus Pembrolizumab plus Pemetrexed and Carboplatin/Cisplatin in Patients with previously Untreated Advanced Non-Squamous Non-Small-Cell Lung Cancer
Protocol code: BO42592
Sponsor: F. Hoffmann-La Roche AG (Pharmaceutical company). Phase: Phase II and Phase III (Integrated). Countries: Spain (ended), France (ended), Denmark (ended), Belgium (ended), Germany (ended), Poland (ended).
Therapeutic area(s): Diseases [C] - Neoplasms [C04]
Gender: Female, Male. Age: 18-64 years, 65+ years. Enrolment: 149.
Status: Ended. Start date (EU): 2020-12-17. End date (EU): 2025-08-22. End date: 2025-11-20. Decision date: 2024-06-07. Results received: Yes. Last updated: 2025-09-27.
Decision dates by country: DE: 2024-06-11, FR: 2024-06-12, PL: 2024-07-01, BE: 2024-06-07, DK: 2024-06-10, ES: 2024-06-11

Condition(s): Non-squamous non-small cell lung cancer (NSCLC)
Product: Tecentriq 1 200 mg concentrate for solution for infusion, KEYTRUDA 25 mg/mL concentrate for solution for infusion, Tiragolumab placebo, Tiragolumab

Primary endpoint: 1. Investigator-Assessed Confirmed Objective Response Rate (ORR) (Phase 2), 2. Investigator-Assessed Progression-free survival (PFS) (Phase 2 and Phase 3), 3. Overall survival (Phase 3)
Endpoint(s): 1. Overall survival (Phase 2), 2. PFS as determined by an independent review facility (IRF) (Phase 3), 3. PFS and OS in patients with PD L1 expression at TC ≥50% and TC ≥1% cut-off, as determined by central testing with Ventana PD-L1 (SP263) assay (Phase 3), 4. PFS at 6 months and 12 months (Phase 3), 5. OS rate at 12 months and 24 months (Phase 3), 6. Confirmed ORR (Phase 3), 7. Duration of response for patients with a confirmed objective response, defined as the time from first occurrence of a confirmed objective response to disease progression or death from any cause (whichever occurs first) (Phase 2 and Phase 3), 8. Time to confirmed deterioration (TTCD) in patient-reported physical functioning and global health status/quality of life (GHS/QoL), as measured by the European Organisation for Research and Treatment of Cancer (EORTC) Quality-of-Life Questionnaire Core 30 (QLQ-C30), and in patient-reported lung cancer symptoms for cough, dyspnea (a multi-item subscale), and chest pain, as measured through the use of the EORTC Quality-of-Life Questionnaire Lung Cancer Module (QLQ-LC13) (Phase 2 and Phase 3), 9. Percentage of Participants with Adverse Events (AEs) (Phase 2 and Phase 3), 10. Frequency of patients’ response of the degree they are troubled with treatment symptoms, as assessed through use of the single-item EORTC IL46 (Phase 2 and Phase 3), 11. Serum concentrations of tiragolumab and atezolizumab (Phase 2 and Phase 3), 12. Percentage of participants with anti-drug antibodies (ADAs) to tiragolumab (Phase 2 and Phase 3), 13. Percentage of participants with ADAs to atezolizumab (Phase 2 and Phase 3)

Source: https://euclinicaltrials.eu/ctis-public/view/2022-502031-20-00